EU clinical trial 2024-511301-31-00: AN OPEN-LABEL, RANDOMIZED STUDY TO EVALUATE THE RELATIVE BIOAVAILABILITY OF A NEW TABLET FORMULATION OF MINZASOLMIN AND THE POTENTIAL EFFECT OF FOOD ON THE PHARMACOKINETICS OF MINZASOLMIN IN HEALTHY PARTICIPANTS
Protocol code: UP0152
Sponsor: UCB Biopharma (Pharmaceutical company). Phase: Human Pharmacology (Phase I)- Other. Countries: Germany (ended).
Therapeutic area(s): Diseases [C] - Nervous System Diseases [C10]
Gender: Female, Male. Age: 18-64 years. Enrolment: 18.
Status: Ended. Start date (EU): 2024-09-06. End date (EU): 2024-11-17. Decision date: 2024-09-03. Results received: Yes. Last updated: 2024-11-06.

Condition(s): Healthy Participants
Product: Minzasolmin, UCB0599 PRD4385815

Primary endpoint: Area under the plasma concentration-time curve from time 0 to t of minzasolmin tablets under fasted conditions, Area under the plasma concentration-time curve from time 0 to t of minzasolmin granules in capsules under fasted conditions, Area under the plasma concentration-time curve from time 0 to t of minzasolmin tablets under fed conditions, Area under the plasma concentration-time curve from zero to infinity of minzasolmin tablets under fasted conditions, Area under the plasma concentration-time curve from zero to infinity of minzasolmin granules in capsules under fasted conditions, Area under the plasma concentration-time curve from zero to infinity of minzasolmin tablets under fed conditions, Maximum plasma concentration (Cmax) of minzasolmin tablets under fasted conditions, Maximum plasma concentration (Cmax) of minzasolmin granules in capsules under fasted conditions, Maximum plasma concentration (Cmax) of minzasolmin tablets under fed conditions
Endpoint(s): Occurrence of treatment-emergent adverse events (TEAEs), Occurrence of serious treatment-emergent adverse events (serious TEAEs), Occurrence of TEAEs leading to withdrawal from study

Source: https://euclinicaltrials.eu/ctis-public/view/2024-511301-31-00